EU clinical trial 2022-502249-90-00: A Multicenter, Randomized, Double-blind, Placebo- controlled, Parallel-group, Dose-ranging Study to Evaluate the Efficacy and Safety of DC-806 in Participants with Moderate to Severe Plaque Psoriasis
Protocol code: DCE806201
Sponsor: DICE Therapeutics Inc. (Pharmaceutical company). Phase: Therapeutic exploratory (Phase II). Countries: Spain (ended), Poland (ended), Hungary (ended), Czechia (ended), Germany (ended).
Therapeutic area(s): Diseases [C] - Skin and Connective Tissue Diseases [C17]
Gender: Female, Male. Age: 18-64 years, 65+ years. Enrolment: 206.
Status: Ended. Start date (EU): 2023-08-31. End date (EU): 2024-03-25. End date: 2024-03-26. Decision date: 2023-08-17. Results received: Yes. Last updated: 2024-04-22.
Decision dates by country: HU: 2023-08-18, PL: 2023-08-21, ES: 2023-08-18, DE: 2023-08-21, CZ: 2023-08-17

Condition(s): Plaque Psoriasis
Product: DC-806 Placebo tablets, DC-806, DC-806, DC-806, DC-806

Primary endpoint: • Proportion of participants achieving ≥75% reduction in Psoriasis Area of Severity Index score (PASI-75) at Week 12 • Incidence proportion of TEAEs, SAEs, and TEAEs leading to discontinuation
Endpoint(s): • Proportion of participants in each DC-806 treatment group achieving PASI-75 at Week 12 • Proportion of participants achieving an sPGA score of 0 (clear) or 1 (almost clear) with ≥2 grade improvement from Baseline at Week 12, • Proportion of participants achieving ≥50%, ≥75%, ≥90%, and 100% reduction in PASI score (PASI-50, PASI-75, PASI-90, and PASI-100, respectively) at all scheduled timepoints • Proportion of participants achieving an sPGA score of 0 or 1 at all scheduled timepoints, • Change and percent change from Baseline in PASI score at all scheduled timepoints • Change and percent change from Baseline in the percentage of BSA affected at all scheduled timepoints • Measurement of plasma concentration of DC-806 at scheduled timepoints

Source: https://euclinicaltrials.eu/ctis-public/view/2022-502249-90-00